EU clinical trial 2025-522896-27-00: An open label extension study to evaluate the long-term safety and efficacy of subcutaneous lunsekimig in adult participants with asthma who participated in study DRI16762 or ACT18301
Protocol code: LTS17231
Sponsor: Sanofi-Aventis Recherche & Developpement (Pharmaceutical company). Phase: Therapeutic exploratory (Phase II). Countries: Poland (authorised, recruitment pending), Italy (authorised, recruitment pending), Belgium (authorised, recruitment pending), Sweden (temporarily halted), Hungary (authorised, recruitment pending), France (authorised, recruitment pending), Germany (ongoing, recruiting), Spain (ongoing, recruiting), Denmark (ended).
Therapeutic area(s): Diseases [C] - Respiratory Tract Diseases [C08]
Gender: Female, Male. Age: 18-64 years, 65+ years. Enrolment: 90.
Start date (EU): 2026-05-11. Decision date: 2026-03-02. Results received: No. Last updated: 2026-03-06.
Decision dates by country: BE: 2026-03-02, DK: 2026-03-02, FR: 2026-03-03, DE: 2026-03-03, HU: 2026-03-06, IT: 2026-03-04, ES: 2026-03-06, SE: 2026-03-02, PL: 2026-03-04

Condition(s): Asthma

Primary endpoint: Number of participants having any treatment-emergent adverse event (TEAE), including adverse events of special interest (AESI), and serious adverse event (SAE)
Endpoint(s): Annualized rate of asthma exacerbation events, Annualized rate of asthma exacerbation events, Change from parent study baseline in pre-bronchodilator (BD) forced expiratory volume in 1 second (FEV1), Change from parent study baseline in pre bronchodilator (BD) FEV1, Change from parent study baseline in Asthma Control Questionnaire-5 (ACQ-5) score, Change from parent study baseline in Asthma Control Questionnaire 5 (ACQ-5) score, Proportion of participants with ≥0.5-point reduction in each score as compared to parent study baseline score, Proportion of participants with ≥0.5-point reduction in each score as compared to parent study baseline score, Change from parent study baseline in Asthma Quality of Life Questionnaire with Standardized Activities for 12 years and older (AQLQ[S] + 12) domain and total scores, Change from parent study baseline in Asthma Quality of Life Questionnaire with Standardized Activities for 12 years and older (AQLQ[S] +12) domain and total scores, Serum lunsekimig concentrations, Incidence and titer of anti-drug antibodies (ADA) against lunsekimig

Source: https://euclinicaltrials.eu/ctis-public/view/2025-522896-27-00